EU clinical trial 2024-511495-32-00: A Global Multicenter, Open Label, Randomized, Phase 3 Registrational Study of Olverembatinib (HQP1351) in Patients with Chronic Phase Chronic Myeloid Leukemia (POLARIS-2)
Protocol code: HQP1351CG301
Sponsor: Ascentage Pharma Group Inc. (Pharmaceutical company). Phase: Therapeutic confirmatory (Phase III). Countries: Germany (authorised, recruiting), Poland (ongoing, recruiting), France (ongoing, recruiting), Belgium (ongoing, recruiting), Spain (ongoing, recruiting), Italy (ongoing, recruiting).
Therapeutic area(s): Diseases [C] - Neoplasms [C04]; Diseases [C] - Hemic and Lymphatic Diseases [C15]
Gender: Female, Male. Age: 18-64 years, 65+ years. Enrolment: 68.
Start date (EU): 2025-04-16. Decision date: 2025-01-20. Results received: No. Last updated: 2026-06-15.
Decision dates by country: PL: 2025-01-27, FR: 2025-01-24, BE: 2025-01-21, ES: 2025-01-20, IT: 2025-01-24, DE: 2025-01-22

Condition(s): Chronic Phase Chronic Myeloid Leukemia
Product: Bosulif 100 mg film-coated tablets, Bosulif 500 mg film-coated tablets, Olverembatinib

Primary endpoint: Part A: MMR rate at 24 weeks, Part B: MMR rate by 24 weeks
Endpoint(s): Part A: MMR rate at 96 weeks, Part A: Cytogenetic response rate (complete, partial, major, minor, minimal, no response) at and by all scheduled data collection time points, including 24, 48 and 96 weeks, Part A: MMR, MR4, MR4.5 rate at all scheduled data collection time points (except 24 and 96 weeks which are already covered by primary and key secondary endpoints), Part A: MMR, MR4, MR4.5 rate by all scheduled data collection time points including 24, 48 and 96 weeks, Part A: Time to MMR, MR4, MR4.5, Part A: Duration of MMR, MR4, MR4.5, Part A: Time to complete cytogenetic response (CCyR), Part A: Duration of CCyR, Part A: Time to treatment failure, Part A: Progression free survival, Part A: OS, Part A: Type, frequency, and severity of adverse events, Part A:Changes in laboratory values that fall outside the normal ranges and clinically notable ECG and other safety data (vital signs, physical examination), Part A:Trough plasma concentration; key PK parameters including apparent clearance, apparent volume of distribution and other appropriate parameters, Part A: Change in health utility from baseline over time according to EQ-5D-5L, Part A: Change in work productivity and activity impairment over time according to WPAI- GH, Part B: MMR rate by 96 weeks, Part B:Cytogenetic response rate (complete, partial, major, minor, minimal, no response) by all scheduled data collection time points, including 24, 48 and 96 weeks, Part B:MMR, MR4, MR4.5 rate by all scheduled data collection time points (except 24 and 96 weeks, which are already covered by primary and key secondary endpoints), Part B:Time to MMR, MR4, MR4.5, Part B:Duration of MMR, MR4, MR4.5, Part B:Time to CCyR, Part B:Duration of CCyR, Part B: Time to treatment failure, Part B:Progression free survival, Part B:OS, Part B:Type, frequency, and severity of adverse events., Part B:Changes in laboratory values that fall outside the normal ranges and clinically notable ECG and other safety data (vital signs, physical examination), Part B:Trough plasma concentration; key PK parameters including apparent clearance, apparent volume of distribution and other appropriate parameters, Part B:Change in QoL from baseline over time according to EORTC QLQ-C30, Part B:Change in work productivity and activity impairment over time according to WPAI- GH, Part A: Change in Quality of Life (QoL) over time according to EORTC QLQ-C30, Part B: Change in health utility from baseline over time according to EQ-5D-5L

Source: https://euclinicaltrials.eu/ctis-public/view/2024-511495-32-00